EU clinical trial 2024-516796-33-00: Efficacy of an anti-TSLP monoclonal antibody in the management of chronic bronchial disease induced by bronchiolitis obliterans syndrome in allogeneic hematopoietic stem cells transplantation recipients.
Sponsor: Hospital Foch (Hospital/Clinic/Other health care facility). Phase: Therapeutic exploratory (Phase II). Countries: France (ongoing, recruiting).
Therapeutic area(s): Diseases [C] - Respiratory Tract Diseases [C08]
Gender: Female, Male. Age: 18-64 years, 65+ years. Enrolment: 36.
Status: Ongoing, recruiting. Start date (EU): 2026-06-25. Decision date: 2026-05-27. Results received: No. Last updated: 2026-05-27.

Condition(s): The medical condition studied in IMMUNO-BOS is Bronchiolitis obliterans syndrome (BOS) after allogeneic stem cell transplantation
Product: Tezspire 210 mg solution for injection in pre-filled syringe

Primary endpoint: The primary endpoint is the within-patient change in the annualized number of bronchial exacerbations between the 12-month period prior to treatment initiation and the 12-month treatment period. Bronchial exacerbations will be defined as acute bronchial symptoms lasting more than 48h and requiring hospitalization and/or anti infectious or corticosteroids.
Endpoint(s): Endpoints evaluating the improvement of respiratory symptoms and corticosteroids sparing (secondary objective n°1): Clinical outcomes: • Number of days alive and not exacerbating • Number of days alive and not hospitalized • Reduction in corticosteroids regimen (inhaled and/or systemic route) Outcomes from validated questionnaires: • ACQ6 score (Asthma Control Questionnaire 6) • Breathlessness, Cough and Sputum Scale (BCSS) • St George Respiratory Questionnaire (SGRQ), 2 Functionnal outcomes: • Pre-bronchodilator spirometry [forced expiratory volume in 1 second, forced vital capacity and the FEV1/FVC ratio. • Pre- bronchodilator plethysmography [total lung capacity, residual volume and the TLC/RV ratio] • Inspiratory and expiratory oscillometry parameters: resistance at 5 Hz, reactance at 5 Hz, Frequence of resonnance, Immunological outcomes: • Blood eosinophilia (absolute count, G/L) • Eosinophilia in induced sputum (relative count, %) • Blood total IgE count (kUI/L), Exhalomic outcomes Unsupervised analysis of VOCs in exhaled air of patients blowing in a quadrupole-time-of-flight mass spectrometer (PTR-Qi-TOF MS; Ionicon, Innsbruck, Austria). Identification of VOCs (peaks corresponding to m/z) significantly changing over the year of treatment and correlation with clinical and biological readouts.

Source: https://euclinicaltrials.eu/ctis-public/view/2024-516796-33-00